EU clinical trial 2024-518409-16-00: Actuate 1801: Phase 1/2 Study of Elraglusib (9-ING-41), a Glycogen Synthase Kinase-3 Beta (GSK-3β) Inhibitor, as a Single Agent and Combined with Chemotherapy, in Patients with Refractory Hematologic Malignancies or Solid Tumors
Protocol code: 1801
Sponsor: Actuate Therapeutics Limited (Pharmaceutical company). Phase: Phase I and Phase II (Integrated)- First administration to humans. Countries: Portugal (ended), Belgium (ongoing, recruitment ended), France (ended), Spain (ended).
Therapeutic area(s): Diseases [C] - Neoplasms [C04]
Gender: Female, Male. Age: 18-64 years, 65+ years. Enrolment: 225.
Start date (EU): 2021-04-14. Decision date: 2024-10-30. Results received: No. Last updated: 2025-08-19.
Decision dates by country: FR: 2024-11-19, ES: 2024-10-30, PT: 2024-10-31, BE: 2024-10-31

Condition(s): Refractory Hematologic Malignancies or Solid Tumors
Product: Gemcitabine 100 mg/ml Concentrate for Solution for Infusion, 9-ING-41, Abraxane 5 mg/ml powder for dispersion for infusion.

Primary endpoint: 1-year survival rate of patients treated on the Elraglusib schedule chosen from the run-in portion of the study compared to the control arm.
Endpoint(s): Disease control rate (DCR), defined as: Stable disease for ≥16 weeks, confirmed complete response, or confirmed partial response., Objective response rate (ORR), defined as the percent of patients with Complete Response (CR) or Partial Response (PR) according to the Response Evaluation Criteria in Solid Tumors, Version 1.1 (RECIST 1.1) criteria relative to the efficacy population., Duration of Response (DOR), defined as the time from documentation of tumor response to disease progression, Progression-Free Survival (PFS), defined as the time from study enrolment until objective tumor progression or death, OS, defined as the time from study entry to death from any cause, Time to Treatment Failure (TTF), Adverse events will be monitored from the date of first administration of Elraglusib and ending 30 days after the final administration of Elraglusib using the Common Terminology Criteria for Adverse Events (CTCAE), v5.0, Correlation of disease control rate with tumor molecular profiles

Source: https://euclinicaltrials.eu/ctis-public/view/2024-518409-16-00